EU clinical trial 2022-502890-40-00: FIRE Stones : Impact of Furosemide on the residual fragment rate after flexible ureteroscopy for destruction of kidney stones with laser : a controlled two-parallel group multicenter trial with blinding evaluation
Protocol code: DR220258
Sponsor: Centre Hospitalier Regional Universitaire De Tours (Hospital/Clinic/Other health care facility). Phase: Therapeutic confirmatory (Phase III). Countries: France (ongoing, recruiting).
Therapeutic area(s): Analytical, Diagnostic and Therapeutic Techniques and Equipment [E] - Therapeutics [E02]
Gender: Female, Male. Age: 18-64 years, 65+ years. Enrolment: 374.
Status: Ongoing, recruiting. Start date (EU): 2024-01-04. Decision date: 2023-09-27. Results received: No. Last updated: 2026-02-19.

Condition(s): Destruction of kidney stones
Product: FUROSEMIDE

Primary endpoint: Stone-free rate at 3 months of a flexible ureteroscopy for renal stone laser destruction, evaluated on the low dose abdomino-pelvic CT-Scan. A centralized review of the images will be performed by two specialized radiologists, in a blind and crossed way to allow a homogenization of the results
Endpoint(s): Post-operative urinary tract infection will be assessed within 30 days after surgery on the combination of: - Fever higher than 38.5°C and/or, - Chills and/or, - Clinical symptoms (supra-pubic pain, dysuria, pollakiuria, urgency, urinary burning, back pain radiating to the genitals, hematuria) and/or - Positive urine culture with a significant bacteriuria threshold., Post-operative pain will be assessed using a numerical pain scale ranging from 0 to 10 in the recovery room, in the service and at the discharge., Furosemide adverse events will be assessed., Effect of the prescription of an alpha-blocker will be looked at considering the primary outcome, Evaluation of agreement between the imaging analysis of the urologist and the specialized radiologist will be looked at considering the primary outcome. Urologists will assess CT-Scan while the study is going on while specialized radiologists will assess the CT Scan at the end of the study.

Source: https://euclinicaltrials.eu/ctis-public/view/2022-502890-40-00